EU clinical trial 2024-514945-12-00: DANTE / FLOT8 A randomized, open-label Phase II/III efficacy and safety study of atezolizumab in combination with FLOT versus FLOT alone in patients with gastric cancer and adenocarcinoma of the oesophago-gastric junction and high immune responsiveness (MO30039/MO43340)– The IKF-DANTE Trial A Trial of AIO in collaboration with SAKK
Protocol code: DANTE/FLOT8
Sponsor: Frankfurter Institut Fuer Klinische Krebsforschung IKF GmbH (Pharmaceutical company). Phase: Phase II and Phase III (Integrated). Countries: Germany (ongoing, recruitment ended).
Therapeutic area(s): Diseases [C] - Neoplasms [C04]
Gender: Female, Male. Age: 18-64 years, 65+ years. Enrolment: 624.
Status: Ongoing, recruitment ended. Start date (EU): 2018-09-03. Decision date: 2024-08-09. Results received: No. Last updated: 2026-06-02.

Condition(s): locally advanced resectable adenocarcinoma of the oesophagogastric junction or the stomach
Product: Docetaxel Accord 20 mg/1 ml concentrate for solution for infusion, 5-FU medac 50 mg/ml, Injektionslösung, Tecentriq 1 200 mg concentrate for solution for infusion, Oxaliplatin medac 5 mg/ml concentrate for solution for infusion, Leucovorin 10 mg/ml Lösung zur Injektion/ Infusion

Primary endpoint: Primary Endpoint Phase III: Event-free survival EFS, defined as the time from randomization to disease progression or relapse after surgery or death from any cause, Primary Endpoint Phase II (exploratory): pCR or TRG 1a rate where pCR is defined as the absence of residual tumor based on evaluation of the resected esophagogastric specimen in the primary (as assessed by local pathology) and postoperative TNM (pTNM) stage according to the 8th version of the UICC classification (as assessed by local pathology) – both as exploratory endpoints
Endpoint(s): Rate of pathological complete responses (pCR, TRG1a) as assessed according to the Becker criteria, Rate of pathological complete and subtotal remission (pCR+pSR, TRG1a/b) as assessed according to the Becker criteria, R0 resection rate, Overall survival (OS) (Phase III only), OS and EFS in the subgroups of patients with PD-L1 CPS score ≥ 5 and ≥ 10 and patients with MSI (Phase III only), Safety (according to NCI-CTCAE V 4.03) and tolerability, Perioperative morbidity and mortality rates, ctDNA exploratory endpoints

Source: https://euclinicaltrials.eu/ctis-public/view/2024-514945-12-00